EU clinical trial 2023-503669-50-00: A Phase III, Randomized, Double-Masked, Placebo-Controlled, Multicenter Study to Evaluate the Efficacy, Safety, Pharmacokinetics, and Pharmacodynamics of Satralizumab in Participants with Moderate-to-Severe Thyroid Eye Disease
Protocol code: GP44729
Sponsor: F. Hoffmann-La Roche AG (Pharmaceutical company). Phase: Therapeutic confirmatory (Phase III). Countries: Spain (ended), France (ended), Portugal (ended), Poland (ended).
Therapeutic area(s): Diseases [C] - Immune System Diseases [C20]; Diseases [C] - Eye Diseases [C11]
Gender: Female, Male. Age: 18-64 years, 65+ years. Enrolment: 67.
Status: Ended. Start date (EU): 2023-12-27. End date (EU): 2026-06-19. End date: 2026-06-22. Decision date: 2023-10-04. Results received: No. Last updated: 2026-06-08.
Decision dates by country: PT: 2024-09-27, ES: 2023-10-04, FR: 2023-10-06, PL: 2024-09-30

Condition(s): Moderate-to-Severe Thyroid Eye Disease

Primary endpoint: Proportion of participants (with active disease) achieving >= 2mm reduction in proptosis from baseline (Day 1) at Week 24 in the study eye, provided there is no deterioration of proptosis (>= 2mm increase) in fellow eye
Endpoint(s): 1. Proportion of participants with active disease achieving overall response at Week 24, defined as a >= 2-point reduction in CAS, AND a >= 2 mm reduction in proptosis from baseline (Day 1) in the study eye, provided there is no corresponding deterioration in CAS or proptosis (>= 2 point/mm increase) in the fellow eye, 2. Proportion of participants (with active and chronic inactive disease) achieving >= 2 mm reduction in proptosis from baseline (Day 1) at Week 24 in the study eye provided there is no corresponding deterioration in proptosis (>= 2 mm increase) in the fellow eye, 3. Proportion of participants with active disease achieving a >= 2-point reduction in CAS from baseline (Day 1) to Week 24, 4. Change from baseline (Day 1) in proptosis at Week 24 in participants with active disease, 5. Change from baseline (Day 1) in proptosis at Week 24 in participants with active and chronic inactive disease, 6. Proportion of participants with active disease with a >= 6 point improvement in the Visual Functioning and Appearance sub-scale scores of the Grave’s orbitopathy- Quality of Life (GO-QoL) questionnaire from baseline at Week 24, 7. Proportion of participants with active and chronic inactive disease with a >= 6 point improvement in the Visual Functioning and Appearance sub- scale scores of the Grave’s orbitopathy- Quality of Life (GO-QoL) questionnaire from baseline from week 24 at Week 48, 8. Proportion of participants with active disease achieving >= 1 grade reduction/improvement in diplopia at Week 24 among participants with baseline diplopia, 9. Proportion of participants with active and chronic inactive disease achieving >= 1 grade reduction/improvement in diplopia at Week 24 among participants with baseline diplopia, 10. Proportion of participants with active disease achieving absence of motility-induced pain at Week 24 among participants with motilityinduced pain at baseline, 11. Proportion of participants with active disease achieving absence of spontaneous pain at Week 24 among participants with spontaneous pain at baseline, 12. Proportion of participants with a >= 6-point improvement in the Visual Functioning and Appearance sub-scale scores of the GO-QoL from baseline (Day 1) to Week 48, 13 . Incidence, seriousness, and severity of adverse events (AEs), with severity determined according to National cancer institute common terminology criteria for adverse events version 5 (NCI CTCAE V5), 14 . Change from baseline (Day 1) in vital signs, targeted clinical laboratory test results, electrocardiogram (ECG) parameters, and body weight, 15 . Serum concentration of satralizumab at specified timepoints, 16 . Estimates of primary PK parameters (e.g., CL/F and V/F) and secondary PK parameters (e.g., AUC) derived using popPK modeling

Source: https://euclinicaltrials.eu/ctis-public/view/2023-503669-50-00